EU clinical trial 2023-504789-48-00: Bioequivalence study between two fluticasone propionate 500μg/salmeterol 50μg inhalation powders
Protocol code: BECRO/RESP/AEROPK500
Sponsor: Respirent Pharmaceuticals Co. Ltd. (Pharmaceutical company). Phase: Human Pharmacology (Phase I)- Bioequivalence Study. Countries: Greece (ended).
Therapeutic area(s): Diseases [C] - Respiratory Tract Diseases [C08]
Gender: Female, Male. Age: 18-64 years. Enrolment: 34.
Status: Ended. Start date (EU): 2023-08-23. End date (EU): 2024-03-22. Decision date: 2023-07-13. Results received: No. Last updated: 2023-07-13.

Condition(s): Healthy volunteers: regular treatment of bronchial asthma, where a combination product containing a corticosteroid and a long-acting beta2-adrenergic agonist (LABA) is indicated for: •Twice-daily treatment of asthma in patients aged 4 years and older. •Maintenance treatment of airflow obstruction and reducing exacerbations in patients with chronic obstructive pulmonary disease (COPD).

Source: https://euclinicaltrials.eu/ctis-public/view/2023-504789-48-00